EU clinical trial 2024-515985-16-00: Dexamethasone in Herpes Simplex Virus Encephalitis Open label Randomized Controlled Trial with an Observer-blinded evaluation at 6 months
Protocol code: 38RC16.015
Sponsor: Centre Hospitalier Universitaire Grenoble Alpes (Hospital/Clinic/Other health care facility). Phase: Therapeutic confirmatory (Phase III). Countries: France (ended).
Therapeutic area(s): Diseases [C] - Virus Diseases [C02]
Gender: Female, Male. Age: 18-64 years, 65+ years. Enrolment: 35.
Status: Ended. Start date (EU): 2019-04-25. End date (EU): 2025-05-07. Decision date: 2024-09-13. Results received: No. Last updated: 2024-09-13.

Condition(s): Herpes Simplex Virus Encephalitis
Product: Dexamethasone 20mg/5ml Oral Solution

Primary endpoint: Verbal memory score, as determined by the Wechsler Memory Scale (WMS-IV) Auditory Memory Index at 6 months, single blind evaluation
Endpoint(s): Neuropsychological outcome measures [6 months and 18 months]: - Visual, immediate and delayed memory (WMS-IV), Processing speed and working memory(WAIS-IV), & Higher executive function (Trail Making Tests Past A and B) - Anxiety and Depression (BDI & BAI), Cognitive Outcome Measures [at 30 days/discharge, 6 and 18 months] : - Addenbrooke’s Cognitive Assessment revised (ACE-III), Clinical Outcome: - Incidence of epilepsy - Time to hospital discharge - Requirement of HDU/ITU admission - Time to cessation of ventilator support [if any] - Time to recovery of GCS - Survival, Functional Outcomes [at 30 days/discharge, 6 months and 18 months] : - Modified Rankin Score, Barthel Index, Liverpool Outcome Score and Glasgow Outcome Score, Biomarker outcomes [Baseline, 4 days, 2 weeks, 6 months months]: - Transcriptomic and proteomic profiling on blood at baseline, 4 days, 2 weeks and 6 months & CSF at baseline and 2 weeks - Anti NMDA receptor antibody testing at 4 days (and 2 weeks and 6 months if necessary), Safety Outcomes [2 weeks]: - Proportion of patients with detectable HSV in CSF, Health Status and Quality of Life [at 6 and 18 months] :- Measured by the EuroQOL-5D-5L and SF-36

Source: https://euclinicaltrials.eu/ctis-public/view/2024-515985-16-00